EU clinical trial 2024-517185-42-00: Phase 1 study of a Propranolol (HEMANGIOL®) and oral metronomic Vinorelbine (NAVELBINE®) combination on children and teenagers With Refractory/Relapsing Solid Tumors - PROVIN
Protocol code: PROVIN
Sponsor: Centre Hospitalier Regional De Marseille (Hospital/Clinic/Other health care facility). Phase: Human Pharmacology (Phase I)- Other. Countries: France (temporarily halted).
Therapeutic area(s): Diseases [C] - Neoplasms [C04]
Gender: Female, Male. Age: 0-17 years, 18-64 years. Enrolment: 58.
Status: Temporarily halted. Start date (EU): 2020-05-04. Decision date: 2024-09-05. Results received: No. Last updated: 2026-06-04.

Condition(s): Children and teenagers with refractory/relapsing solid tumor
Product: PROPRANOLOL HYDROCHLORIDE, NAVELBINE 30 mg, capsule molle, Propranolol Teva 40 mg, comprimé sécable, HEMANGIOL 3.75 mg/mL oral solution, NAVELBINE 20 mg, capsule molle

Primary endpoint: Maximum tolerated dose (MTD) assessed over the first two treatment cycles (D1 to D56) according to the NCI-CTC v5.0 scale and defined as follows: - Grade 3 or 4 neutropenia requiring treatment deferral of more than 7 days - Grade 3 or 4 thrombocytopenia requiring transfusions for more than 7 days - Grade 3 or 4 non-hematological toxicity, with the exception of : - nausea and vomiting - grade 3 fever, - grade 3 liver toxicity reversible after 14 days
Endpoint(s): Tolerance judged using NCI-CTC v5.0 scale, PK performed by liquid chromatography coupled with either mass spectrometry (LCMSMS) or UV detection, Efficacy: Progression-free survival 2, 4, 6, 12, 18 and 24 months of treatmentand overall survival after 6, 12, 18 and 24 months of treatment, and response rate according to RECIST, SIOPEN or WHO criteria. PFS will be calculated from study entry to the date of progression or death (if related to tumor or treatment toxicities). Overall survival will be calculated from study entry to date of death.

Source: https://euclinicaltrials.eu/ctis-public/view/2024-517185-42-00